EU clinical trial 2025-524942-87-00: Prognostic value of early assessment by ⁶⁸Ga-DOTATATE PET/CT for the treatment of well-differentiated grade 2 gastroenteropancreatic neuroendocrine tumors with ¹⁷⁷Lutetium-oxodotreotide.”
Sponsor: Centre De Lutte Contre Le Cancer Eugene Marquis (Hospital/Clinic/Other health care facility). Phase: Therapeutic use (Phase IV). Countries: France (authorised, recruitment pending).
Therapeutic area(s): Diseases [C] - Neoplasms [C04]
Gender: Female, Male. Age: 18-64 years, 65+ years. Enrolment: 40.
Status: Authorised, recruitment pending. Decision date: 2026-05-18. Results received: No. Last updated: 2026-05-18.

Condition(s): Gastroenteropancreatic neuroendocrine tumors
Product: SomaKit TOC 40 micrograms kit for radiopharmaceutical preparation

Primary endpoint: Progression-free survival is defined as the time from the first injection of ¹⁷⁷Lu-oxodotreotide to the occurrence of the first documented tumor progression according to RECIST 1.1 criteria during CT follow-up.
Endpoint(s): Progression-free survival is defined as the time from the first injection of ¹⁷⁷Lu-oxodotreotide to the occurrence of the first documented tumor progression according to RECIST 1.1 criteria during CT follow-up. Tumor assessment is performed every 3 months after treatment initiation using CT and RECIST 1.1 criteria. ⁶⁸Ga-edotreotide PET/CT images acquired immediately before the third injection of ¹⁷⁷Lu-oxodotreotide will be independently analyzed

Source: https://euclinicaltrials.eu/ctis-public/view/2025-524942-87-00